EU clinical trial 2024-515329-27-00: Comparison of the effects of prophylactic administration of Apixaban on thrombin generation in patients with de novo multiple myeloma and patients undergoing a surgery for total knee replacement: the ProApix Study
Protocol code: 23CH293
Sponsor: Centre Hospitalier Universitaire De Saint Etienne (Hospital/Clinic/Other health care facility). Phase: Therapeutic use (Phase IV). Countries: France (ongoing, recruiting).
Therapeutic area(s): Diseases [C] - Neoplasms [C04]; Diseases [C] - Cardiovascular Diseases [C14]
Gender: Female, Male. Age: 18-64 years, 65+ years. Enrolment: 32.
Status: Ongoing, recruiting. Start date (EU): 2025-06-24. Decision date: 2024-11-06. Results received: No. Last updated: 2025-05-14.

Condition(s): Thromboembolism prophylaxis
Product: Apixaban Teva GmbH 2,5 mg filmdragerade tablette

Primary endpoint: The primary endpoint is the endogenous thrombin potential (ETP) measured by thrombinography using the MidiCAT method at peak concentration after administration of a 2.5mg dose in patients treated for de novo multiple myeloma (group 1) or operated on for total knee replacement (group 2) with a sample taken 2 hours after the first dose of ‘Apixaban’. ETP is expressed as the concentration of active thrombin multiplied by time (nM.min).
Endpoint(s): Measurement of Apixaban concentration (in ng/mL) by mass spectrometry during the 12 hours following administration of a dose of Apixaban 2.5mg in both groups., Evaluation of the pharmacodynamic evolution kinetics of thrombin generation (using the parameters ETP (nM/min), Lagtime (min), Time to peak (min), Thrombin peak (M Thrombin) in the presence and absence of thrombomodulin in both groups at H0, H2, H6 and H12 of Apixaban administration using the MidiCAT method., Modelling of the pharmacokinetic-pharmacodynamic relationship in each group., Evaluation of changes in pharmacokinetics (Apixaban dosage in ng/mL) and pharmacodynamics (thrombin generation using the MidiCAT method) after 5 cycles of chemotherapy +/- 1 cycle for patients in group 1.

Source: https://euclinicaltrials.eu/ctis-public/view/2024-515329-27-00